EU clinical trial 2023-506269-78-00: A PHASE 3, RANDOMIZED, DOUBLE-BLIND, PLACEBO-CONTROLLED, FIXED-DOSE, MULTICENTER STUDY TO EXAMINE THE EFFICACY AND SAFETY OF ZX008 IN SUBJECTS WITH CDKL5 DEFICIENCY DISORDER FOLLOWED BY AN OPEN-LABEL EXTENSION
Protocol code: ZX008-2103/EP0216
Sponsor: Zogenix International Limited (Pharmaceutical company). Phase: Therapeutic confirmatory (Phase III). Countries: Belgium (ended), Italy (ended), Ireland (ended), Germany (ongoing, recruitment ended), Spain (ended), Portugal (ended), Austria (ended), Netherlands (ongoing, recruitment ended).
Therapeutic area(s): Diseases [C] - Nervous System Diseases [C10]
Gender: Female, Male. Age: 0-17 years, 18-64 years. Enrolment: 62.
Start date (EU): 2023-06-20. Decision date: 2024-08-05. Results received: No. Last updated: 2026-04-25.
Decision dates by country: IE: 2024-08-06, DE: 2024-08-08, AT: 2024-08-12, NL: 2024-08-05, PT: 2024-08-06, IT: 2024-08-12, BE: 2024-08-08, ES: 2024-08-07

Condition(s): CDKL5 Deficiency disorder
Product: Fintepla 2.2 mg/ml oral solution, Fenfluramine hydrochloride, Placebo matching the drug product fenfluramine hydrochloride oral solution without active substance., Fenfluramine hydrochloride

Primary endpoint: Percentage change from Baseline in CMSF during Titration and Maintenance Periods (T+M) (Part 1), Treatment-emergent adverse events (TEAEs) (Part 2), Abnormal physical examination findings (Part 2), Abnormal neurological examination findings (Part 2), Positive response to self-harm question (Part 2), Increase in valvular regurgitation from baseline (except absent to trace) (Part 2), Pulmonary arterial hypertension (PASP > 35 mmHg) at any time during treatment on repeat testing (Part 2), Change from Baseline at end of OLE1 Period in Laboratory parameters (hematology, hormones, chemistry, urinalysis) (Part 2), Change from Baseline at end of OLE1 Period in Vital signs (blood pressure, heart rate, temperature, and respiratory rate) (Part 2), Change from Baseline at end of OLE1 Period in Body weight (Part 2), Change from Baseline at end of OLE1 Period in Tanner Staging (Part 2), Treatment-emergent adverse events (TEAEs) (Part 3), Change from Baseline at end of OLE2 Period in height and/or body weight (Part 3), Increase in valvular regurgitation from baseline (except absent to trace) (Part 3), Pulmonary arterial hypertension (PASP > 35 mmHg) at any time during treatment on repeat testing (Part 3)
Endpoint(s): Achievement of a ≥ 50% reduction from Baseline in CMSF during T+M (Part 1), Achievement of a CGI-I rating of much or very much improved as assessed by the Investigator at the end of T+M (Part 1), Percentage change from Baseline in monthly GTC seizure frequency during T+M (Part 1), Achievement of Categorized Percentage change in seizures from Baseline in CMSF during T+M Periods (no reduction or worsening, ≥ 25%, ≥ 75%, or 100% reduction), Achievement of “near seizure freedom” (0 or 1 seizures) during T+M (Part 1), Achievement of a CGI-I rating of much or very much improved as assessed by the parent/caregiver at the end of T+M (Part 1), Achievement of improvement (minimal, much, or very much improved) in the CGI-I rating as assessed, independently, by the Investigator at the end of T+M (Part 1), Achievement of improvement (minimal, much, or very much improved) in the CGI-I rating as assessed, independently, by the parent/caregiver at the end of T+M (Part 1), Percentage change from Baseline in the monthly frequency of all seizures during T+M (Part 1), Change from Baseline in the monthly frequency of CMS-free days during T+M (Part 1), Treatment-emergent adverse events (TEAEs) (Part 1), Abnormal physical examination findings (Part 1), Abnormal neurological examination findings (Part 1), Positive response to self-harm question (Part 1), Increase in valvular regurgitation from baseline (except absent to trace) (Part 1), Pulmonary arterial hypertension (PASP > 35 mmHg) at any time during treatment on repeat testing (Part 1), Change from Baseline in Laboratory parameters (hematology, hormones, chemistry, urinalysis) (Part 1), Change from Baseline in Vital signs (blood pressure, heart rate, temperature, and respiratory rate) (Part 1), Change from Baseline in Body weight Part 1), Change from Baseline in Tanner Staging (Part 1), Percentage change from Baseline in CMSF during the OLE1 Treatment Period (Part 2), Achievement of Categorized Percentage change in seizures from Baseline in CMSF during OLE1 Treatment Period (no reduction or worsening, ≥ 25%, ≥ 50%, ≥ 75%, or 100% reduction) (Part 2), Achievement of “near seizure freedom” (0 or 1 seizures) during T+M (Part 2), Achievement of a CGI-I rating of much or very much improved as assessed by the Investigator and by the parent/caregiver at the end of the OLE1 Treatment Period (Part 2), Achievement of improvement (minimal, much, or very much improved) in the CGI-I rating as assessed by the Investigator at the end of the OLE1 Treatment Period (Part 2), Achievement of improvement (minimal, much, or very much improved) in the CGI-I rating as assessed by the Parent/Caregiver at the end of the OLE1 Treatment Period (Part 2), Percentage change from Baseline in monthly GTC seizure frequency during the OLE1 Treatment Period (Part 2), Change from Baseline in the monthly frequency of CMS-free days during the OLE1 Treatment Period (Part 2)

Source: https://euclinicaltrials.eu/ctis-public/view/2023-506269-78-00